EU clinical trial 2024-516383-28-01: Surgical versus Medical Treatment in Microprolactinomas (SUMET PRO)
Sponsor: Azienda Unita Sanitaria Locale Di Bologna (Hospital/Clinic/Other health care facility). Phase: Therapeutic confirmatory (Phase III). Countries: Italy (authorised, recruitment pending).
Therapeutic area(s): Diseases [C] - Hormonal diseases [C19]; Diseases [C] - Nervous System Diseases [C10]
Gender: Female, Male. Age: 18-64 years, 65+ years. Enrolment: 88.
Status: Authorised, recruitment pending. Decision date: 2024-09-23. Results received: No. Last updated: 2024-09-23.

Condition(s): Microprolactinomas
Product: DOSTINEX 0,5 mg compresse

Primary endpoint: Prolactin levels will be measured on single fasting venous sampling at 6- and 12-month follow up to determine the rate of biochemical remission in patients treated with EES or CAB
Endpoint(s): To determine m-PRL remnant at MRI with g.c.m. performed at 6 and 12 months after EES or starting CAB. MRI with g.c.m will be performed at study enrollment (baseline) and at 6- and 12- month follow-up to evaluate m-PRL diameters, so the ability of EES and CAB to reduce tumor mass., To determine in patients treated with CAB the rate of drug resistance (defined as failure to achieve normal prolactin levels and a reduction of adenoma size <50% on maximally tolerated doses after at least 6 months of treatment) through the measurement of prolactin levels at baseline and at 6- and 12-month follow-up.

Source: https://euclinicaltrials.eu/ctis-public/view/2024-516383-28-01